EU clinical trial 2023-505259-39-00: A phase 1/2a, first-in-human, open-label, multicenter, dose escalation study of MP0533 in patients with acute myeloid leukemia (AML) or myelodysplastic syndrome (MDS)
Protocol code: MP0533-CP101
Sponsor: Molecular Partners AG (Pharmaceutical company). Phase: Phase I and Phase II (Integrated)- First administration to humans. Countries: France (ongoing, recruitment ended), Netherlands (ended), Lithuania (ended).
Therapeutic area(s): Diseases [C] - Neoplasms [C04]
Gender: Female, Male. Age: 18-64 years, 65+ years. Enrolment: 221.
Start date (EU): 2023-03-02. Decision date: 2023-10-10. Results received: No. Last updated: 2026-03-18.
Decision dates by country: FR: 2023-10-18, NL: 2023-10-10, LT: 2023-10-27

Condition(s): Acute Myeloid Leukemia (AML), Myelodysplastic Syndrome (MDS)
Product: Venclyxto 100 mg film-coated tablets, MP0533, Vidaza 25 mg/ml powder for suspension for injection

Primary endpoint: Incidence of CRS and non-CRS DLTs during the first cycle of treatment (phase 1 only), Type, incidence and severity of AEs according to National Cancer Institute Common Terminology Criteria for Adverse Events (NCI CTCAE) v5.0, Changes in laboratory safety parameters and vital signs, Overall response rate (ORR) based on best overall response of complete remission, complete remission with partial hematological recovery (CRh); complete remission with incomplete hematological recovery (CRi), morphologic leukemia-free state (MLFS) and partial remission (PR) according to the European LeukemiaNet (ELN) response criteria 2022 (phase 2a only)
Endpoint(s): Determination of PK parameters including (but not limited to) Cmax, time at Cmax (Tmax), minimal serum concentration (Cmin), area under the concentration-time curve (AUC), total CL, volume of distribution (Vd) and t1/2, Different levels of CR, CRh, Cri, MLFS and PR according to the ELN response criteria 2022, separately and pooled, Event free survival (EFS) based on ELN response criteria 2022, Duration of response (DoR) based on ELN response criteria 2022, Overall survival (OS) (phase 2a only), Number of patients proceeding to a stem cell transplantation (phase 2a only), Transfusion-Independence (TI)

Source: https://euclinicaltrials.eu/ctis-public/view/2023-505259-39-00